EU clinical trial 2024-515452-20-00: A Phase 2, Parallel-Group, Dose-Range-Finding Study With Randomized Double-Blind Treatment and Open-Label Periods to Evaluate the Safety and Efficacy of ALKS 2680 in Subjects With Narcolepsy Type 2
Protocol code: ALKS 2680-202
Sponsor: Alkermes Inc. (Pharmaceutical company). Phase: Therapeutic exploratory (Phase II). Countries: Spain (ended), Czechia (ended), France (ended), Italy (ended), Netherlands (ended), Belgium (ended).
Therapeutic area(s): Diseases [C] - Nervous System Diseases [C10]
Gender: Female, Male. Age: 18-64 years, 65+ years. Enrolment: 124.
Status: Ended. Start date (EU): 2025-04-01. End date (EU): 2025-11-11. End date: 2025-11-21. Decision date: 2025-03-13. Results received: No. Last updated: 2026-01-13.
Decision dates by country: ES: 2025-03-19, IT: 2025-03-19, CZ: 2025-03-13, FR: 2025-04-07, NL: 2025-03-14, BE: 2025-03-14

Condition(s): Narcolepsy Type 2
Product: Placebo to match ALKS 2680, ALKS 2680, ALKS 2680, ALKS 2680

Primary endpoint: • Change in the MSL on MWT from baseline to Week 8 by dose level • Change in ESS from baseline to Week 8 by dose level
Endpoint(s): • TEAEs by study period • Clinical laboratory assessments by study period • Vital signs by study period • Safety ECG by study period • C-SSRS by study period

Source: https://euclinicaltrials.eu/ctis-public/view/2024-515452-20-00